EU clinical trial 2023-509219-97-00: Randomized, crossover, two-period, two-treatment, comparative bioavailability study of ibuprofen (arginine) granules for oral solution, developed by Farmalider, S.A., and Espidifen® granules for oral solution, administered in single dose of 600 mg to healthy subjects under fasting conditions.
Protocol code: FMLD- IO600-58-1
Sponsor: Farmalider S.A. (Pharmaceutical company). Phase: Human Pharmacology (Phase I)- Other. Countries: Spain (ended).
Therapeutic area(s): Not possible to specify
Gender: Female, Male. Age: 18-64 years. Enrolment: 30.
Status: Ended. Start date (EU): 2024-04-01. End date (EU): 2024-05-17. Decision date: 2024-03-20. Results received: No. Last updated: 2024-03-20.

Condition(s): Healthy volunteers

Source: https://euclinicaltrials.eu/ctis-public/view/2023-509219-97-00